EU clinical trial 2024-514147-28-00: A multicentre, randomized, open-label study of romiplostim plus dexamethasone vs dexamethasone in patients with newly diagnosed primary immune thrombocytopenia
Protocol code: RODEX
Sponsor: Fundacion Publica Andaluza Para La Gestion De La Investigacion En Salud De Sevilla (Laboratory/Research/Testing facility). Phase: Therapeutic confirmatory (Phase III). Countries: Spain (ongoing, recruitment ended), Italy (ongoing, recruitment ended).
Therapeutic area(s): Diseases [C] - Hemic and Lymphatic Diseases [C15]
Gender: Female, Male. Age: 18-64 years, 65+ years. Enrolment: 86.
Status: Ongoing, recruitment ended. Start date (EU): 2022-12-02. Decision date: 2024-07-15. Results received: No. Last updated: 2026-02-10.
Decision dates by country: IT: 2024-07-23, ES: 2024-07-15

Condition(s): Primary immune thrombocytopenia
Product: DEXAMETHASONE, Nplate 250 micrograms powder for solution for injection, Nplate 500 micrograms powder and solvent for solution for injection

Primary endpoint: To evaluate the difference between study arms in the proportion of patients achieving 6mSROT-50 at 6 months (180 days) from treatment cessation. Definition of 6mSROT-50: platelets higher or equal than 50x109/L in the absence of any ITP treatment including any rescue treatment for at least 6 consecutive months (≥180 days) from treatment cessation and without WHO grade 2 or more bleeding.
Endpoint(s): -To evaluate the difference between study arms in the proportion of patients achieving 6mSROT-30 at 6 months (180 days) from treatment cessation. -To evaluate the difference between study arms in the proportion of patients achieving 12mSROT-50 at 12 months (365 days) from treatment cessation. -To evaluate the difference between study arms in the proportion of patients achieving 12mSROT-30 at 12 months (365 days) from treatment cessation

Source: https://euclinicaltrials.eu/ctis-public/view/2024-514147-28-00